EU clinical trial 2024-512291-34-00: A phase 3, randomized, open-label, multi-country study to evaluate the immunogenicity, safety, reactogenicity and persistence of a single dose of the RSVPreF3 OA investigational vaccine and different revaccination schedules in adults aged 60 years and above.
Protocol code: 212496
Sponsor: GlaxoSmithKline Biologicals (Pharmaceutical company). Phase: Therapeutic confirmatory (Phase III). Countries: Finland (ongoing, recruitment ended), Germany (ongoing, recruitment ended).
Therapeutic area(s): Diseases [C] - Virus Diseases [C02]
Gender: Female, Male. Age: 18-64 years, 65+ years. Enrolment: 738.
Status: Ongoing, recruitment ended. Start date (EU): 2021-02-22. Decision date: 2024-06-04. Results received: No. Last updated: 2026-02-10.
Decision dates by country: DE: 2024-06-05, FI: 2024-06-04

Condition(s): Respiratory Syncytial Virus Infections
Product: Arexvy powder and suspension for suspension for injection Respiratory Syncytial Virus (RSV) vaccine (recombinant, adjuvanted)

Primary endpoint: Humoral immune response at pre-vaccination (Day 1), 30 days post-Dose 1 (Day 31), and at 6 and 12 months post-Dose 1 (Months 6 and 12), in a subset of participants: Neutralizing titers against RSV-A. Neutralizing titers against RSV-B.
Endpoint(s): Humoral immune response at pre-vaccination (Day 1), 30 days post-Dose 1 (Day 31), and at 6 and 12 months post-Dose 1 (Months 6 and 12), in a subset of participants: RSVPreF3-binding Immunoglobulin G (IgG) antibody concentrations., Humoral immune response at Months 18, 24, 30, 36, 42, 48, 54 and 60 post-Dose 1, and at 1 month after each revaccination dose (Months 13, 25, 37 and 49), in a subset of participants: Neutralizing titers against RSV-A and RSV-B RSVPreF3-binding IgG antibody concentrations., CMI response at pre-vaccination (Day 1), 30 days post Dose 1 (Day 31), at Months 6, 12, 18, 24, 30, 36, 42, 48, 54 and 60 post-Dose 1, and after each revaccination dose (Months 13, 25, 37, 49, 61, 66 and 72), in a subset of participants: Frequency of RSVPreF3-specific CD4+ and/or CD8+ T cells expressing at least 2 activation markers including at least one cytokine among CD40L, 4-1BB, IL-2, TNF-α, IFN-γ, IL-13, IL-17., • Occurrence of each solic. admin. site + systemic event during a 4-day Fup period (i.e., on the day of vaccination and 3 subsequent days) after each vaccination. • Occurrence of any unsolic. AE during a 30-day Fup period (i.e., on the day of vaccination and 29 subsequent days) after each vaccination. • Occurrence of all SAEs and pIMDs up to 6 months after each vaccination. • Occurrence of fatal SAEs, related SAEs and related pIMDs from first vaccination (D1) up to study end (M72).

Source: https://euclinicaltrials.eu/ctis-public/view/2024-512291-34-00